EU clinical trial 2025-522484-15-00: Adjuvant Dynamic marker - Adjusted Personalized Therapy comparing adjuvant Elacestrant with standard endocrine treatment in genomically and/or clinically high-risk ER+/HER2- early breast cancer (ADAPTela)
Protocol code: WSG-AM16
Sponsor: WSG Westdeutsche Studiengruppe GmbH (Pharmaceutical company). Phase: Therapeutic confirmatory (Phase III). Countries: Germany (ongoing, recruiting), Spain (authorised, recruitment pending), Austria (authorised, recruitment pending).
Therapeutic area(s): Diseases [C] - Neoplasms [C04]
Gender: Female, Male. Age: 18-64 years, 65+ years. Enrolment: 1520.
Start date (EU): 2026-04-27. Decision date: 2026-03-11. Results received: No. Last updated: 2026-08-02.
Decision dates by country: DE: 2026-03-11, AT: 2026-03-22, ES: 2026-03-19

Condition(s): ER+/HER2- early breast cancer
Product: Kisqali 200 mg film-coated tablets, Kisqali 200 mg film-coated tablets, Kisqali 200 mg film-coated tablets, ORSERDU 345 mg film-coated tablets, ORSERDU 86 mg film-coated tablets, Kisqali 200 mg film-coated tablets

Primary endpoint: iDFS, compared between patients randomized to adjuvant elacestrant (+/-CDK4/6i) or SOC ET (+/- CDK4/6i)
Endpoint(s): OS defined as time from first diagnosis to death, dDFS, RFS, DFS-DCIS, IBCFS, LRFS, each as defined in STEEP 2.0, Change of HRQoL between baseline, measured after completion of SoC primary treatment (including (neo)adjuvant chemotherapy, surgery, further local therapy), and on following defined timepoints: before start of treatment, 6-monthly during treatment until year 3 and yearly afterwards., Long-term survival endpoints, Survival outcomes in premenopausal patients with N0 + RS 16-25 and N1 + RS 0-25 treated by ovarian function suppression (OFS) in combination with either aromatase inhibitor or tamoxifen (SoC) +/- ribociclib (in stage II) or elacestrant +/- ribociclib (in stage II) without chemotherapy use, Comparison of toxicity of regimen by evaluation of adverse events of special interest (AESI)-, adverse drug reaction (ADR)-, serious adverse drug reaction (SADR)-, and serious adverse event (SAE)-rates.

Source: https://euclinicaltrials.eu/ctis-public/view/2025-522484-15-00